EU clinical trial 2024-516797-29-00: A phase II, open-label study improving compliance and time of treatment after obtaining complete response through a tailored schedule of sonidegib in locally advanced basal cell carcinomas (BCC) – the SONIBEC trial
Sponsor: Fondazione GONO Plus (Laboratory/Research/Testing facility). Phase: Therapeutic exploratory (Phase II). Countries: Italy (ongoing, recruitment ended).
Therapeutic area(s): Diseases [C] - Neoplasms [C04]
Gender: Female, Male. Age: 18-64 years, 65+ years. Enrolment: 21.
Status: Ongoing, recruitment ended. Start date (EU): 2021-01-12. Decision date: 2024-10-16. Results received: No. Last updated: 2026-04-29.

Condition(s): locally advanced basal cell carcinoma
Product: Odomzo 200 mg hard capsules

Primary endpoint: Proportion of patients maintaining the tailored treatment with sonidegib 12 months after enrolment into the study.
Endpoint(s): Compliance with the study treatment (number of sonidegib cps assumed/number of sonidegib cps foreseen during the study period)., Proportion of patients maintaining treatment 2 years after achieving CR., Proportion of patients who experimented relapses after sonidegib interruption for causes other than disease progression at 1 year after achieving CR., Proportion of patients who experimented relapse after sonidegib interruption for causes other than disease progression at 2 years after achieving CR., Safety of the tailored sonidegib schedules (schedule 1: 14 days on - 14 days off; schedule 2: 7 days on – 21 days off) measured by CTCAE scale. AEs and SAEs will be described as number of events and percentages, stratified for grade., Quality of life measured by monthly ESAS (Edmonton Symptom Assessment System scales. The QoL scores for each domain and the overall QoL will be described and possible significant predictors of the QoL scores will be analysed using the Chi-square test or the Wilcoxon t test, when appropriate., Use of concomitant medication and use of medical resources to manage toxicities caused by the study drug (e.g., general practitioner’s consultation, other medical visits, etc). Number of drugs and access to medical visits will be registered for descriptive purposes., Dermoscopic Evaluation: Dermoscopic images of the lesion area will be obtained using a videodermatoscope. Changes during treatment period will be described and correlate with drug response., Translational analysis: characteristics of mutation in Hh pathway genes of BCC pre and post-treatment and evaluation of microenvironment in naive and pre-treated BCC.

Source: https://euclinicaltrials.eu/ctis-public/view/2024-516797-29-00